EU clinical trial 2022-502831-20-00: A Phase I trial to establish the safety and maximum tolerated dose of high-affinity autologous BCMA-targeting CAR-T cells in patients with relapsed and refractory B-cell malignancies (CARLOTTA01)
Protocol code: TUD-BCMACA-078
Sponsor: Technische Universitat Dresden (Educational Institution). Phase: Human Pharmacology (Phase I)- First administration to humans. Countries: Germany (ongoing, recruiting).
Therapeutic area(s): Diseases [C] - Neoplasms [C04]
Gender: Female, Male. Age: 18-64 years, 65+ years. Enrolment: 16.
Status: Ongoing, recruiting. Start date (EU): 2024-02-15. Decision date: 2023-11-03. Results received: No. Last updated: 2023-11-03.

Condition(s): Male and female adult patients with relapsed Multiple Myeloma or Diffuse large B-cell Non-Hodgkin’s Lymphoma shall be treated in the trial.

Source: https://euclinicaltrials.eu/ctis-public/view/2022-502831-20-00